EU clinical trial 2023-508457-10-00: Randomized, Single-blind, Placebo-controlled Clinical Trial to Evaluate the Safety and Efficacy of Melatonin Administration in Patients With Multiple Progressive Primary Sclerosis (MELATOMS)
Protocol code: MELATOMS-1
Sponsor: Fundacion Publica Andaluza Para La Gestion De La Investigacion En Salud De Sevilla (Laboratory/Research/Testing facility). Phase: Phase I and Phase II (Integrated)- First administration to humans. Countries: Spain (ended).
Therapeutic area(s): Diseases [C] - Nervous System Diseases [C10]
Gender: Female, Male. Age: 18-64 years, 65+ years. Enrolment: 50.
Status: Ended. Start date (EU): 2024-11-15. End date (EU): 2026-02-18. Decision date: 2024-11-15. Results received: No. Last updated: 2024-11-15.

Condition(s): Primary Progressive Multiple Sclerosis
Product: MELATONIN, Excipient No. 1 for Fagron capsules (200 milligrams), Composition: 98.05% microcrystalline cellulose AND 1.95% colloidal silica.

Primary endpoint: Disease progression: rates of neurological impairment (Kurtzke Expanded Disability Status Scale) and rates of disability (Multiple Sclerosis Functional Composite - MSFC scale).
Endpoint(s): Number of participants with treatment-related adverse events, Cerebral atrophy, Fatigue, Quality of life, Sleep disorders, Spasticity, Efficacy of neuroinflammation, Axonal damage, Oxidative stress, Impact on microbiota

Source: https://euclinicaltrials.eu/ctis-public/view/2023-508457-10-00